EU clinical trial 2025-520995-24-00: Efficacy of an empirical treatment with Amoxicillin-clavulanate (AC) compared to the combination Amoxicillin-clavulanate and Ciprofloxacin (AC+C) in the outpatient care of chemotherapy-induced fever in adult haematology patients. AC-CIF Protocol
Protocol code: P23/12
Sponsor: Centre Hospitalier De Versailles (Hospital/Clinic/Other health care facility). Phase: Therapeutic confirmatory (Phase III). Countries: France (authorised, recruitment pending).
Therapeutic area(s): Diseases [C] - Hemic and Lymphatic Diseases [C15]; Diseases [C] - Bacterial Infections and Mycoses [C01]
Gender: Female, Male. Age: 18-64 years, 65+ years. Enrolment: 1526.
Status: Authorised, recruitment pending. Decision date: 2025-08-18. Results received: No. Last updated: 2025-12-24.

Condition(s): Adult patients treated for haematological disorders, in whom chemotherapy regimens are expected to induce neutropenia lasting <7 days
Product: AMOXICILLIN AND BETA-LACTAMASE INHIBITOR, CIPROFLOXACIN

Primary endpoint: Clinical success, defined as apyrexia measured 4 days after the first antibiotic dose, without modification of antibiotic treatment
Endpoint(s): Clinical criteria: a) Fever recurrence before Day 14 (fever surveillance form Day 1 to Day 14; H48; Day 4; Day 14); b) Hospitalization for treatment failure (H48; Day 4; Day 14, Day 30); c) Hospitalization in intensive care unit for treatment failure (H48; Day 14, Day30); d) Death (Day 14, Day 30) e) Death due to infection (Day 14, Day 30), Therapeutic criteria: a) Adequacy of empirical antibiotic treatment to the treatment prescribed at randomization (H48; Day 4; Day 14) b) Treatment compliance (treatment compliance surveillance form Day1 to Day 7) c) Any modification in antibiotic treatment (H48; Day 4; Day 14) d) Treatment with a beta-lactam antibiotic with efficacy against P. aeruginosa (Day 14) e) Antibiotic duration (Day 14), Microbiological criteria: a) Bacteraemia (in the subgroup of secondarily hospitalized patients) (Day 14) b) Empirical antibiotic treatment inefficient against identified bacteria (in the subgroup of secondarily hospitalized patients) (Day 14) c) Pseudomonas aeruginosa bacteraemia (Day 14), Adverses Events: AE and SAE will be collected at every follow-up visit. Eval at H48 by phone call (hospitalization, vital status). Eval at Day 14 by phone call, review of medical charts and retrospective collection of biological and microbiological data (hospitalization, vital status, occurrence of the following events: tendinous pain, joint pain, confusion, QT prolongation, cardiac rhythm disorder, allergy, C. difficile colitis). Eval at Day 30 by phone call (hospit + vital status)

Source: https://euclinicaltrials.eu/ctis-public/view/2025-520995-24-00